EU clinical trial 2023-504581-29-00: A Phase 1/2, First-in-Human, Open-Label, Dose Escalation Study of Talquetamab, a Humanized GPRC5D x CD3 Bispecific Antibody, in Subjects with Relapsed or Refractory Multiple Myeloma
Protocol code: 64407564MMY1001
Sponsor: Janssen - Cilag International (Pharmaceutical company). Phase: Phase I and Phase II (Integrated)- First administration to humans. Countries: Spain (ongoing, recruitment ended), France (ongoing, recruitment ended), Netherlands (ongoing, recruitment ended), Poland (ongoing, recruitment ended), Belgium (ongoing, recruitment ended), Germany (ongoing, recruitment ended).
Therapeutic area(s): Diseases [C] - Neoplasms [C04]
Gender: Female, Male. Age: 18-64 years, 65+ years. Enrolment: 291.
Status: Ongoing, recruitment ended. Start date (EU): 2018-04-26. Decision date: 2024-02-22. Results received: No. Last updated: 2026-07-30.
Decision dates by country: DE: 2024-02-25, BE: 2024-03-01, FR: 2024-03-05, NL: 2024-02-22, PL: 2024-02-29, ES: 2024-02-26

Condition(s): Multiple myeloma
Product: RoActemra 20 mg/mL concentrate for solution for infusion, JNJ-64407564, RoActemra 20 mg/mL concentrate for solution for infusion, Tyenne 20 mg/ml concentrate for solution for infusion, JNJ-64407564, JNJ-64407564, Tyenne 20 mg/ml concentrate for solution for infusion, JNJ-64407564

Primary endpoint: Part 1 and Part 2: Frequency and type of DLT; frequency and severity of adverse events, serious adverse events, and laboratory abnormalities, Part 3: ORR (PR or better) as defined by the IMWG criteria based on review by the IRC, Occurrence and severity of TEAEs, serious TEAEs, adverse events of clinical interest, and ORR [PR or better], DOR, VGPR or better/CR or better/sCR, TTR, PFS, and OS.

Source: https://euclinicaltrials.eu/ctis-public/view/2023-504581-29-00